EU clinical trial 2022-501899-26-00: Double-blind, randomized, active-controlled, two-way cross-over study, with 12-week treatment duration per period, to evaluate the efficacy and safety of QMF149 (indacaterol acetate / mometasone furoate) compared to budesonide in children from 6 to less than 12 years of age with asthma
Protocol code: CQMF149G2301
Sponsor: Novartis Pharma AG (Pharmaceutical company). Phase: Therapeutic confirmatory (Phase III). Countries: Portugal (ongoing, recruiting), Hungary (ongoing, recruiting), Greece (ongoing, recruiting), Spain (ongoing, recruiting), Romania (ongoing, recruiting), Czechia (ended), Austria (ended), Italy (ongoing, recruiting), Bulgaria (ongoing, recruiting).
Therapeutic area(s): Diseases [C] - Respiratory Tract Diseases [C08]
Gender: Female, Male. Age: 0-17 years. Enrolment: 94.
Start date (EU): 2023-09-01. Decision date: 2023-05-24. Results received: No. Last updated: 2026-07-24.
Decision dates by country: RO: 2023-05-29, CZ: 2023-05-24, HU: 2023-05-26, ES: 2023-05-25, AT: 2023-05-30, PT: 2023-05-25, BG: 2025-06-16, GR: 2023-05-25, IT: 2023-05-24

Condition(s): Asthma
Product: FLUTICASONE PROPIONATE, Miflonide Breezhaler, inhalationspulver, hård kapsel, The training kit placebo is a generic Placebo hard non-gelatin capsule, inhalation. It is used to match an active dosage form in a clinical trial. The placebo comprises inactive excipients (magnesium stearate and lactose monohydrate) encapsulated in hard non-gelatin capsules matching those used for the active drug product., FLUTICASONE PROPIONATE, FLUTICASONE PROPIONATE, SALBUTAMOL, QMF149

Primary endpoint: Change from baseline in improving lung function (FEV1) at Week 12 of each treatment period.
Endpoint(s): Change from baseline in pediatric asthma symptoms (ACQ-IA), peak air flow out of the lungs (PEFR) score and the number of asthma flare ups at Week 12 of each treatment period., Measure use of rescue medication changes (daytime, night-time, and daily) over 12 weeks of each treatment period., All untoward effects happening in the study will be assessed to understand the safety of QMF149 in comparison with Budesonide based on clinical assessments, labs, ECGs and history.

Source: https://euclinicaltrials.eu/ctis-public/view/2022-501899-26-00